EU clinical trial 2024-518355-36-01: Evaluation of the Novel Therapeutic Hepatitis B Virus Synthetic Long Peptide Vaccination ISA104 (HEB-PEP)
Sponsor: Erasmus Universitair Medisch Centrum Rotterdam (Erasmus MC) (Hospital/Clinic/Other health care facility). Phase: Human Pharmacology (Phase I)- First administration to humans. Countries: Netherlands (ongoing, recruiting).
Therapeutic area(s): Diseases [C] - Virus Diseases [C02]
Gender: Female, Male. Age: 18-64 years. Enrolment: 24.
Status: Ongoing, recruiting. Start date (EU): 2024-11-27. Decision date: 2024-11-27. Results received: No. Last updated: 2025-09-22.

Condition(s): chronic Hepatitis B

Source: https://euclinicaltrials.eu/ctis-public/view/2024-518355-36-01